EU clinical trial 2025-522781-77-01: Dosing EvaLuation of Tenofovir Alafenamide on Epstein-Barr Virus (The DELTA-EBV study)
Sponsor: Helse Bergen HF (Hospital/Clinic/Other health care facility). Phase: Therapeutic exploratory (Phase II). Countries: Norway (ongoing, recruiting).
Therapeutic area(s): Diseases [C] - Virus Diseases [C02]
Gender: Female, Male. Age: 18-64 years, 65+ years. Enrolment: 45.
Status: Ongoing, recruiting. Start date (EU): 2026-06-10. Decision date: 2026-05-28. Results received: No. Last updated: 2026-05-28.

Condition(s): Epstein-Barr virus infection
Product: Vemlidy 25 mg film-coated tablets

Primary endpoint: Number of participants experiencing treatment-emergent adverse events (AEs).
Endpoint(s): Within-participants changes in EBV shedding frequency in saliva, defined as number of samples with detectable levels of EBV during sequential dose escalation., Within-participant changes in EBV viral load in saliva during sequential dose escalation., Within-participant changes in EBV specific CD4 T cells by ELISPOT assay during sequential dose escalation., Within-participant changes in IgG antibodies to EBNA1 and VCA during sequential dose escalation., Secondary safety endpoints related to the IMP

Source: https://euclinicaltrials.eu/ctis-public/view/2025-522781-77-01